EU clinical trial 2024-512745-16-00: A Phase 3, Double-blind, Randomized, Placebo-Controlled, Multicenter Study Evaluating the Efficacy and Safety of Mitapivat in Subjects With Non–Transfusion-Dependent Alpha or Beta Thalassemia (ENERGIZE)
Protocol code: AG348-C-017
Sponsor: Agios Pharmaceuticals Inc. (Pharmaceutical company). Phase: Therapeutic confirmatory (Phase III). Countries: Greece (ongoing, recruitment ended), Netherlands (ongoing, recruitment ended), Bulgaria (ongoing, recruitment ended), Denmark (ongoing, recruitment ended), Spain (ongoing, recruitment ended), Italy (ongoing, recruitment ended), France (ongoing, recruitment ended).
Therapeutic area(s): Diseases [C] - Hemic and Lymphatic Diseases [C15]
Gender: Female, Male. Age: 18-64 years, 65+ years. Enrolment: 86.
Status: Ongoing, recruitment ended. Start date (EU): 2022-04-13. Decision date: 2024-07-23. Results received: No. Last updated: 2026-06-16.
Decision dates by country: DK: 2024-07-24, BG: 2024-07-29, FR: 2024-07-25, NL: 2024-07-23, GR: 2024-08-22, ES: 2024-09-05, IT: 2024-09-03

Condition(s): Non–Transfusion-Dependent Alpha- or Beta-Thalassemia
Product: Placebo for Mitapivat, MITAPIVAT

Primary endpoint: Hemoglobin (Hb) response, defined as a ≥1.0 g/dL increase in average Hb concentration from Week 12 through Week 24 compared with baseline

Source: https://euclinicaltrials.eu/ctis-public/view/2024-512745-16-00